EU clinical trial 2024-513035-25-00: A Multicenter, Randomized, Double-blind, Placebo-controlled, Flexible-dose Study to Assess the Efficacy, Safety, and Tolerability of ITI1284 in Patients with Psychosis Associated with Alzheimer’s Disease
Protocol code: ITI-1284-201
Sponsor: Intra-Cellular Therapies Inc. (Pharmaceutical company). Phase: Therapeutic exploratory (Phase II). Countries: Croatia (ongoing, recruiting), Czechia (ongoing, recruiting), Spain (ongoing, recruiting), Poland (ended), Bulgaria (ongoing, recruiting), Slovakia (ongoing, recruiting), Romania (ongoing, recruiting), Italy (authorised, recruitment pending).
Therapeutic area(s): Psychiatry and Psychology [F] - Mental Disorders [F03]
Gender: Female, Male. Age: 18-64 years, 65+ years. Enrolment: 216.
Start date (EU): 2025-07-11. Decision date: 2025-05-12. Results received: No. Last updated: 2026-07-28.
Decision dates by country: PL: 2025-05-19, IT: 2026-01-21, CZ: 2025-05-14, BG: 2025-05-14, SK: 2025-05-12, RO: 2025-05-19, HR: 2025-05-19, ES: 2025-05-16

Condition(s): Psychosis associated with Alzheimer’s Disease
Product: ITI-1284, ITI-1284, ITI-1284 placebo tablets are yellow to off-yellow-cream, circular, freeze-dried units, debossed with a diamond matching the active tablets. The placebo matches both the 10 mg and 20 mg active tablet.

Primary endpoint: the change from baseline to end of Week 6 in BEHAVE-AD psychosis subscale score
Endpoint(s): the change from baseline to end of Week 6 in CGI-S score

Source: https://euclinicaltrials.eu/ctis-public/view/2024-513035-25-00